EU clinical trial 2023-504307-88-00: Double-blind, Randomized, Placebo-controlled Study Evaluating the Safety and Efficacy of Nipocalimab in Reducing the Risk of Fetal and Neonatal Alloimmune Thrombocytopenia (FNAIT) in At-risk Pregnancies
Protocol code: 80202135FNAIT3001
Sponsor: Janssen - Cilag International (Pharmaceutical company). Phase: Therapeutic confirmatory (Phase III). Countries: Germany (not authorised), Spain (ended), Belgium (ongoing, recruiting), Hungary (authorised, recruitment pending), Italy (authorised, recruiting), Sweden (ongoing, recruiting), Slovakia (authorised, recruiting), Norway (ongoing, recruiting), France (authorised, recruitment pending), Slovenia (ongoing, recruiting), Netherlands (not authorised).
Therapeutic area(s): Diseases [C] - Immune System Diseases [C20]
Gender: Female. Age: 18-64 years. Enrolment: 27.
Start date (EU): 2024-02-20. Decision date: 2024-01-23. Results received: No. Last updated: 2026-07-01.
Decision dates by country: DE: 2024-01-29, SI: 2024-04-05, BE: 2024-01-25, SK: 2024-01-23, HU: 2024-07-12, ES: 2024-01-25, IT: 2024-01-23, FR: 2024-07-11, NO: 2024-03-15, SE: 2024-01-26

Condition(s): Fetal and Neonatal Alloimmune Thrombocytopenia (FNAIT)
Product: JNJ-80202135, Saline, 0.9% Sodium Chloride Solution for Injection, JNJ-80202135

Primary endpoint: Adverse outcome of death or adjudicated severe bleeding in utero up to the first week post birth, or platelet count at birth <30×10⁹/l in a fetus/neonate.
Endpoint(s): Platelet count at birth in a neonate, Adjudicated bleeding in utero up to the first week post birth in a fetus/neonate

Source: https://euclinicaltrials.eu/ctis-public/view/2023-504307-88-00